EU clinical trial 2024-520392-27-00: Visualizing beta cells in patients with a history of gestational diabetes.
Sponsor: Radboud universitair medisch centrum Stichting (Hospital/Clinic/Other health care facility). Phase: Therapeutic exploratory (Phase II). Countries: Netherlands (authorised, recruitment pending).
Therapeutic area(s): Phenomena and Processes [G] - Metabolism [G03]
Gender: Female, Male. Age: 18-64 years. Enrolment: 24.
Status: Authorised, recruitment pending. Decision date: 2025-01-13. Results received: No. Last updated: 2025-01-13.

Condition(s): Gestational diabetes
Product: EXENATIDE

Primary endpoint: The main parameter of the study is the quantitative assessment of pancreatic 68Ga-NODAGA-exendin-4 uptake women with and without a history of GDM by PET/CT.
Endpoint(s): The correlation between Ga-exendin tracer accumulation and beta cell function of the subjects

Source: https://euclinicaltrials.eu/ctis-public/view/2024-520392-27-00